EU clinical trial 2024-518804-32-00: Neoadjuvant Immunotherapy with Durvalumab (MEDI4736) in Non-Surgical Early Stage or Locally Advanced Non-Small Cell Lung Cancer (NSCLC) followed by Radical Radiotherapy or Chemoradiotherapy – IDEAR
Protocol code: ESR-18-13828
Sponsor: Instituto Portugues De Oncologia Do Porto Francisco Gentil E.P.E. (Hospital/Clinic/Other health care facility). Phase: Phase I and Phase II (Integrated)- Other. Countries: Portugal (ongoing, recruiting).
Therapeutic area(s): Diseases [C] - Neoplasms [C04]
Gender: Female, Male. Age: 18-64 years, 65+ years. Enrolment: 30.
Status: Ongoing, recruiting. Start date (EU): 2021-02-16. Decision date: 2024-11-26. Results received: No. Last updated: 2024-11-26.

Condition(s): Non-Small Cell Lung Cancer (NSCLC)
Product: IMFINZI 50 mg/mL concentrate for solution for infusion.

Primary endpoint: Rate of patients without Dose-Limiting Toxicity (DLT).
Endpoint(s): Presence of adverse events (AEs), including physical examinations, vital signs, electrocardiograms and laboratory clinically significant abnormalities., Objective Response Rate (ORR) (ORR = Complete response (CR) + partial response (PR)), Pathologic response rate (If tumor downsizing and surgical resection become best treatment option)., Proportion of enrolled patients starting RT/CRT within 4 - 5 weeks after durvalumab administration., Proportion of enrolled patients completing the clinical trial.

Source: https://euclinicaltrials.eu/ctis-public/view/2024-518804-32-00